EU clinical trial 2023-506038-65-00: A Phase 2, Multi-Center, Randomized, Open-Label Trial of BDC-1001 as Single Agent and in Combination with Pertuzumab in Subjects with Human Epidermal Growth Factor Receptor 2–Positive Metastatic Breast Cancer Previously Treated with Trastuzumab Deruxtecan
Protocol code: BBI-20231001
Sponsor: Bolt Biotherapeutics Inc. (Pharmaceutical company). Phase: Therapeutic exploratory (Phase II). Countries: France (ended), Spain (ended), Italy (ended).
Therapeutic area(s): Diseases [C] - Neoplasms [C04]
Gender: Female, Male. Age: 18-64 years, 65+ years. Enrolment: 36.
Status: Ended. Start date (EU): 2024-04-15. End date (EU): 2024-05-14. End date: 2024-09-25. Decision date: 2024-02-12. Results received: Yes. Last updated: 2024-03-12.
Decision dates by country: FR: 2024-02-12, IT: 2024-03-12, ES: 2024-03-11

Condition(s): HUMAN EPIDERMAL GROWTH FACTOR RECEPTOR 2–POSITIVE METASTATIC BREAST CANCER
Product: BDC-1001, PERTUZUMAB

Primary endpoint: Objective response rate according to RECIST v1.1
Endpoint(s): Duration of response, disease control rate, progression free survival, overall survival, Incidence of treatment-emergent AEs and SAEs graded according to NCI CTCAE v5.0, Changes from baseline in vital signs, laboratory values, and ECGs, Cmin and Cmax values will be obtained throughout the study and compared to the PK data from the Phase 1 single agent BDC-1001 study utilizing a population approach, Incidence of anti-drug antibodies

Source: https://euclinicaltrials.eu/ctis-public/view/2023-506038-65-00